EU clinical trial 2024-510655-36-00: A Phase I/II Study of the Safety, Pharmacokinetics, and Preliminary Clinical Activity of BT5528 in Patients with Advanced Malignancies Associated with EphA2 Expression
Protocol code: BT5528-100
Sponsor: Bicycletx Limited (Pharmaceutical company). Phase: Phase I and Phase II (Integrated)- First administration to humans. Countries: Spain (ongoing, recruitment ended), Belgium (ongoing, recruitment ended).
Therapeutic area(s): Diseases [C] - Neoplasms [C04]
Gender: Female, Male. Age: 18-64 years, 65+ years. Enrolment: 63.
Status: Ongoing, recruitment ended. Start date (EU): 2022-02-01. Decision date: 2024-04-25. Results received: No. Last updated: 2026-06-26.
Decision dates by country: ES: 2024-04-25, BE: 2024-04-26

Condition(s): Advanced Malignancies Associated with EphA2 Expression
Product: NIVOLUMAB, BT5528

Primary endpoint: 1. Treatment-emergent adverse events (TEAEs), laboratory, ECG and vital sign abnormalities using CTCAE v5.0 criteria., 2. Dose-limiting toxicities as defined in the protocol., 3. Objective response rate (ORR [CR + PR]), duration of response (DOR), clinical benefit rate (CR + PR + SD ≥4 months), time to tumor progression (TTP), progression-free survival time (PFS), rate of PFS at 6 mos., all assessed per RECIST v1.1 criteria as assessed by the Investigator, and OS.
Endpoint(s): 1. Objective response rate (ORR), duration of response (DOR), clinical benefit rate (CR + PR + SD ≥4 months), time to tumor progression (TTP), progression-free survival time (PFS), rate of PFS at 6 mos., all assessed per RECIST v1.1 criteria, and OS, 2. Treatment-emergent adverse events (TEAEs), laboratory, ECG and vital sign abnormalities using CTCAE v5.0 criteria, 3. Objective response rate (ORR), duration of response (DOR), clinical benefit rate (CR + PR + SD ≥4 months), time to tumor progression (TTP), progression-free survival time (PFS), rate of PFS at 6 mos., all assessed per RECIST v1.1 criteria, per EphA2 expression, and OS., 4. Plasma concentrations of BT5528 and MMAE with appropriate pharmacokinetic derivations such as Cmax, Cmin, AUC, and elimination t½, 5. Measurement of ADA.

Source: https://euclinicaltrials.eu/ctis-public/view/2024-510655-36-00